EU clinical trial 2024-513163-57-00: Permanence of Indocyanine Green in axillary lymph nodes three weeks after subdermal injection in patients with Breast Carcinoma and metastatic lymph nodes: The FLUO Trial
Sponsor: Centro Di Riferimento Oncologico Di Aviano (Hospital/Clinic/Other health care facility). Phase: Therapeutic exploratory (Phase II). Countries: Italy (ongoing, recruiting).
Therapeutic area(s): Diseases [C] - Neoplasms [C04]
Gender: Female. Age: 18-64 years, 65+ years. Enrolment: 10.
Status: Ongoing, recruiting. Start date (EU): 2024-12-20. Decision date: 2024-10-11. Results received: No. Last updated: 2026-03-09.

Condition(s): Breast Cancer
Product: INDOCYANINE GREEN

Primary endpoint: Frequency of patient with at least 3 fluorescent lymph nodes
Endpoint(s): Absolute frequency of total number of fluorescent lymph nodes per patient, Absolute frequency of lymph nodes in group A and in group B, Frequency of lymph nodes with metastases resulting fluorescent, Frequency of fluorescent and non-fluorescent lymph nodes between subgroups of patients with different demographic and clinical characteristics

Source: https://euclinicaltrials.eu/ctis-public/view/2024-513163-57-00